EU clinical trial 2023-504439-42-03: Phase II, Placebo-controlled trial of Cannabidiol for the treatment of alcohol dependence (PLACONCANALDE)
Protocol code: PLACONCANALDE
Sponsor: Hospital Universitario 12 De Octubre (Hospital/Clinic/Other health care facility). Phase: Therapeutic exploratory (Phase II). Countries: Spain (authorised, recruitment pending).
Therapeutic area(s): Psychiatry and Psychology [F] - Behavioral Disciplines and Activities [F04]
Gender: Female, Male. Age: 18-64 years. Enrolment: 118.
Status: Authorised, recruitment pending. Decision date: 2026-06-08. Results received: No. Last updated: 2026-06-08.

Condition(s): alcohol dependence
Product: Placebo to cannabidiol, Cannabidiol

Primary endpoint: To evaluate CBD efficacy on alcohol dependance, To evaluate psychological symptoms involved in alcohol consumptions, To evaluate endocannabinoid system, To evaluate CBD tolerability and safety in alcohol dependents

Source: https://euclinicaltrials.eu/ctis-public/view/2023-504439-42-03